EU clinical trial 2024-511542-39-00: A randomized, double-blind, placebo-controlled adjuvant trial in newly diagnosed primary glioblastoma subjects to assess the efficacy and safety of 2-hydroxyoleic acid (2-OHOA) in combination with radiotherapy and temozolomide standard of care treatment.
Protocol code: MIN-003-1806
Sponsor: Laminar Pharmaceuticals S.A. (Pharmaceutical company). Phase: Phase II and Phase III (Integrated). Countries: Spain (ongoing, recruitment ended), France (ongoing, recruitment ended), Italy (ongoing, recruitment ended).
Therapeutic area(s): Diseases [C] - Neoplasms [C04]
Gender: Female, Male. Age: 18-64 years, 65+ years. Enrolment: 106.
Status: Ongoing, recruitment ended. Start date (EU): 2019-09-16. Decision date: 2024-03-15. Results received: No. Last updated: 2025-10-01.
Decision dates by country: FR: 2024-03-19, IT: 2024-03-22, ES: 2024-03-15

Condition(s): Newly diagnosed primary glioblastoma multiforme (ndGBM)
Product: Temodal 100 mg hard capsules, Temodal 250 mg hard capsules, Placebo, 2-Hydroxyoleic acid sodium salt, Temodal 140 mg hard capsules, Temodal 5 mg hard capsules, Temodal 20 mg hard capsules, Temodal 180 mg hard capsules

Primary endpoint: • PFS according to RANO criteria evaluated after at least 66 PFS events occur. Occurrence of disease progression to calculate PFS will be determined first by the investigator based on local evaluation of images and other clinical information. Progression will be confirmed by an adjudication/imaging committee. • Overall Survival evaluated after at least 90 OS events are observed.
Endpoint(s): • Changes in neurological function, based on Neurologic Assessment in Neuro-Oncology (NANO) criteria • To evaluate additional measures of efficacy including: o Time to Progression (TTP) (as assessed using RANO criteria) • HRQoL assessed using the European Organization for Research and Treatment of Cancer Quality of Life Questionnaire, EORTC-QLQ C30, version 3.0 and brain cancer specific QLQ-BN20. • Please refer to protocol for full list

Source: https://euclinicaltrials.eu/ctis-public/view/2024-511542-39-00